EU clinical trial 2022-502357-34-00: A Randomized, Double-Blind, Placebo-Controlled Study of Trilaciclib vs Placebo in Patients with Extensive Stage Small Cell Lung Cancer (ES-SCLC) Receiving Topotecan Chemotherapy
Protocol code: G1T28-211
Sponsor: Pharmacosmos A/S (Pharmaceutical company). Phase: Therapeutic confirmatory (Phase III). Countries: Bulgaria (ongoing, recruitment ended), Poland (ongoing, recruitment ended), Belgium (ongoing, recruitment ended), Germany (ongoing, recruiting), Spain (ongoing, recruitment ended), Austria (ongoing, recruiting), Hungary (ongoing, recruiting), Greece (ongoing, recruitment ended).
Therapeutic area(s): Diseases [C] - Respiratory Tract Diseases [C08]
Gender: Female, Male. Age: 18-64 years, 65+ years. Enrolment: 250.
Start date (EU): 2023-09-27. Decision date: 2023-05-23. Results received: No. Last updated: 2026-02-11.
Decision dates by country: PL: 2023-05-29, AT: 2023-05-24, GR: 2023-12-18, BG: 2023-05-29, ES: 2023-05-24, BE: 2023-05-23, DE: 2023-05-24, HU: 2023-06-12

Condition(s): Extensive Stage Small Cell Lung Cancer
Product: HYCAMTIN 4 mg powder for concentrate for solution for infusion, GLUCOSE MONOHYDRATE, SODIUM CHLORIDE, Topotecan Hikma 4 mg Pulver für ein Konzentrat zur Herstellung einer Infusionslösung, G1T28-1, Topotecanum Accord, 1 mg/ml, koncentrat do sporządzania roztworu do infuzji, Natrium Chloratum 0,9% Baxter, roztwór do infuzji

Primary endpoint: OS is defined as time from randomization to death due to any cause for those who died; or time to last contact known as alive for those who survived in the study (censored cases)
Endpoint(s): PFS is defined as time from randomization to disease progression using RECIST v1.1 or death due to any cause, whichever occurs first; for patients without disease progression or death, PFS will be calculated per censoring rules, ORR, as defined as the proportion of patients with confirmed CR and PR per RECIST v1.1, Duration of objective response per RECIST v1.1, Duration of severe (Grade 4) neutropenia in Cycle 1, Occurrence of severe (Grade 4) neutropenia, Occurrence of febrile neutropenia AEs, Occurrence of G-CSF administration, Occurrence of Grade 3 or 4 decreased hemoglobin laboratory values, RBC transfusions on or after Week 5 (occurrence and number of transfusions), Occurrence of ESA administration, Occurrence of Grade 3 or 4 decreased platelet count laboratory values, Platelet transfusions (occurrence and number of transfusions), Occurrence and number of hospitalizations due to chemotherapy-induced myelosuppression, All-cause dose reductions (occurrence and number of reductions), All-cause cycle delays (occurrence and number of delays), Occurrence and severity of AEs by NCI CTCAE v5.0, Occurrence of study treatment discontinuation due to AEs, Occurrence of Trilaciclib AESIs, Occurrence of Grade 3 or 4 abnormalities in serum chemistry laboratory parameters, Occurrence of trilaciclib infusion interruptions, Occurrence of topotecan infusion interruptions, Relative dose intensity of topotecan

Source: https://euclinicaltrials.eu/ctis-public/view/2022-502357-34-00